EU clinical trial 2025-522848-40-00: Impact of EXercise on quality of life of early breast cancer patients on treatment with adjuvant Aromatase Inhibitors with or without CDK4/6 inhibitors. "The EX-AI study"
Protocol code: GEICAM/2023-09
Sponsor: Fundacion Grupo Espanol De Investigacion En Cancer De Mama (Patient organisation/association). Phase: Therapeutic use (Phase IV). Countries: Spain (ongoing, recruiting).
Therapeutic area(s): Diseases [C] - Neoplasms [C04]
Gender: Female. Age: 18-64 years, 65+ years. Enrolment: 74.
Status: Ongoing, recruiting. Start date (EU): 2026-05-07. Decision date: 2025-12-29. Results received: No. Last updated: 2026-06-10.

Condition(s): Early Breast Cancer
Product: Verzenios 50 mg film-coated tablets, Verzenios 100 mg film-coated tablets, Aromasil 25 mg comprimidos recubiertos, Lutrate Depot Mensual 3,75 mg polvo y disolvente para suspensión inyectable de liberación prolongada, Lutrate Depot Trimestral 22,5 mg polvo y disolvente para suspensión inyectable de liberación prolongada, Verzenios 150 mg film-coated tablets, Zoladex 10,8 mg implantat, Kisqali 200 mg film-coated tablets, Arimidex® 1 mg film-coated tablets, Zoladex 3,6 mg implantat, Femara 2.5 mg Tablets

Primary endpoint: The primary endpoint will consist on determining of the changes from baseline in the QoL-related to ET symptoms measured by the EORTC QLQ-BR45 questionnaire (questions 54-56, 63-69).
Endpoint(s): Change from baseline in global QoL that will be evaluated by questions 29-30 of the EORTC QLQ-C30 questionnaire., AIMSS will be assessed using the Brief Pain Inventory (BPI) scale., Fatigue will be measured by the Brief Fatigue Inventory (BFI) scale., Adherence and compliance to treatment will be recorded using the pill counting method and patient diary, Body composition will be measured by bioimpedance scale. Weight, body mass index (BMI), lean, muscle and fat mass (including visceral fat), water percentage, bone density and basal metabolic rate will be collected, Adherence to the exercise program will be recorded through the exercise professionals’ assistance and assessment through the virtual training platform (called “10 Mets”)., Sexual relations (libido, body image and vaginal dryness) will be evaluated through the specific items included in the EORTC QLQ-BR45 questionnaire (questions 39-42, 44-46 and 70-73)., Cognitive impairment will be evaluated through the specific items included in the EORTC QLQ-C30 questionnaire (questions 20 and 25)., Safety will be assessed by standard clinical and laboratory tests (hematology, serum chemistry). Adverse events (AEs) grade will be defined by the NCI CTCAE (National Cancer Institute Common Terminology Criteria for Adverse Events) version 5.0. Tolerability will be assessed by incidence of treatment dose modifications, discontinuations due to AEs, number of administered cycles, dose intensity, etc.

Source: https://euclinicaltrials.eu/ctis-public/view/2025-522848-40-00